EU clinical trial 2025-524265-24-00: A Double-Blind, Randomized, Comparative Study of Obicetrapib and Bempedoic Acid on top of Maximally Tolerated Lipid-Lowering Therapy in Patients With Dyslipidemia at High to Very High Cardiovascular Risk (MEDICI Study)
Protocol code: AMIL/25/Obi-Dys/001
Sponsor: A. Menarini International Licensing S.A. (Pharmaceutical company). Phase: Therapeutic confirmatory (Phase III). Countries: Spain (ongoing, recruiting), Poland (ongoing, recruiting), Netherlands (authorised, recruiting), Italy (ongoing, recruiting), Slovakia (ongoing, recruiting), Czechia (ongoing, recruiting), Germany (ongoing, recruiting).
Therapeutic area(s): Diseases [C] - Hemic and Lymphatic Diseases [C15]
Gender: Female, Male. Age: 18-64 years, 65+ years. Enrolment: 338.
Start date (EU): 2026-05-21. Decision date: 2026-05-11. Results received: No. Last updated: 2026-07-01.
Decision dates by country: CZ: 2026-05-12, NL: 2026-05-13, SK: 2026-05-11, IT: 2026-05-18, ES: 2026-05-14, PL: 2026-05-15, DE: 2026-05-13

Condition(s): Dyslipidemia at High to Very High Cardiovascular Risk
Product: Nilemdo 180 mg film-coated tablets, Obicetrapib, Bempedoic acid matching placebo, Obicetrapib matching placebo

Primary endpoint: 1. The primary efficacy endpoint is the percentage change from baseline to Day 84 in LDL-C in the OBI group compared to the BPA group.
Endpoint(s): 1. Percentage change from baseline to Day 84 in non-HDL-C in the OBI group compared to the BPA group, 2. Percentage change from baseline to Day 84 in HDL-C in the OBI group compared to the BPA group, 3. Percentage change from baseline to Day 84 in ApoA1 in the OBI group compared to the BPA group, 4. Percentage change from baseline to Day 84 in Lp(a) in the OBI group compared to the BPA group;, 5. Percentage change from baseline to Day 84 in ApoB in the OBI group compared to the BPA group; and, 6. Percentage change from baseline to Day 84 in TGs in the OBI group compared to the BPA group, 7. Overall proportion of participants in the OBI group compared to the BPA group achieving their CV risk-based LDL-C goals, defined as: o High CV risk participants at Day 84 who achieved LDL-C <70 mg/dL (<1.8 mmol/L); and o Very high CV risk participants at Day 84 who achieved LDL-C <55 mg/dL (<1.4 mmol/L)., 8. Safety and tolerability profile of OBI and BPA assessed by AEs, ESIs, physical examinations, vital signs, and clinical laboratory values.

Source: https://euclinicaltrials.eu/ctis-public/view/2025-524265-24-00